EU clinical trial 2024-517114-15-00: Phase I/II study of AGuIX nanoparticles with radiotherapy plus concomitant Temozolomide in the treatment of newly diagnosed glioblastoma
Protocol code: NANO-GBM
Sponsor: Centre Jean Perrin (Patient organisation/association). Phase: Phase I and Phase II (Integrated)- First administration to humans. Countries: France (ongoing, recruitment ended).
Therapeutic area(s): Diseases [C] - Neoplasms [C04]
Gender: Female, Male. Age: 18-64 years, 65+ years. Enrolment: 66.
Status: Ongoing, recruitment ended. Start date (EU): 2025-03-07. Decision date: 2025-01-06. Results received: No. Last updated: 2026-02-11.

Condition(s): newly diagnosed gliblastoma

Primary endpoint: phase I : The recommended dose of AGuIX is defined as the highest dose tested in which the % of dose-limiting toxicities (DLT) is less than 33%. DLT is defined as any grade 3-4 toxicity, except alopecia, nausea, and vomiting, occuring during the first 6 weeks ., phase II : 6-month Progression-free survival rate (RANO criteria)
Endpoint(s): Pharmacokinetic parameters: Cmax, Tmax, AUC et T1/2, Distribution of nanoparticles : after the first and last injection of AGuIX (at S0 and S3). These MRIs will be optional for phase II depending on the participating centers., Overalll survival since the start of treatment. assessment of median survival. The survival rate will be calculated at 6 and 12 months after the start of treatment., the objective response rate according to RANO criteria., The rate 12-month PFS, the median of PFS, The safety profile of AGuIX nanoparticles in combination with radiotherapy and TMZ will be evaluated according to NCI CTC version 5.0 criteria throughout the study, Neurological status will be assessed clinically and using the Mini- Mental State Examination (MMSE) questionnaire, The corticosteroid intake will also be evaluated, The predictive biomarker and tumor microenvironment will be assessed on tumoral bloc (used for glioblastoma diagnosis), local progression time, recurrence patterns (in-field, marginal, out-of-field)

Source: https://euclinicaltrials.eu/ctis-public/view/2024-517114-15-00